EU clinical trial 2023-510176-31-00: An open label, randomized, single-dose, two-sequence, two-period, crossover comparative bioavailability study to assess the pharmacokinetic and safety profile of Dofetilide intravenous solution compared to Tikosyn® (Dofetilide) oral capsule in healthy subjects under fasting conditions.
Protocol code: D052019
Sponsor: Hyloris Developments (Pharmaceutical company). Phase: Human Pharmacology (Phase I)- Other. Countries: Bulgaria (ended).
Therapeutic area(s): Diseases [C] - Cardiovascular Diseases [C14]
Gender: Female, Male. Age: 18-64 years. Enrolment: 20.
Status: Ended. Start date (EU): 2024-07-22. End date (EU): 2024-11-04. Decision date: 2024-07-03. Results received: No. Last updated: 2024-11-01.

Condition(s): This study is a phase I trial, a single-dose, open label, randomized, two-period, two-sequence, crossover bioavailability study comparing IV to oral Dofetilide.

Source: https://euclinicaltrials.eu/ctis-public/view/2023-510176-31-00